EU clinical trial 2025-525124-10-00: A Phase 2, Open-Label Long-Term Extension Study in Participants With Duchenne Muscular Dystrophy Amenable to Exon Skipping to Assess the Long-Term Safety, Tolerability, Pharmacokinetics, and Efficacy of Endosomal Escape Vehicle Phosphorodiamidate Morpholino Oligomer Platform Products (ELEVATE-LTE)
Protocol code: ENTR-601-DMD-202
Sponsor: Entrada Therapeutics Inc. (Pharmaceutical company). Phase: Therapeutic exploratory (Phase II). Countries: Belgium (authorised, recruiting), Italy (authorised, recruitment pending), Netherlands (authorised, recruitment pending), Spain (authorised, recruitment pending).
Therapeutic area(s): Diseases [C] - Musculoskeletal Diseases [C05]
Gender: Male. Age: 0-17 years, 18-64 years. Enrolment: 56.
Start date (EU): 2026-07-29. Decision date: 2026-06-16. Results received: No. Last updated: 2026-06-23.
Decision dates by country: IT: 2026-06-16, ES: 2026-06-22, NL: 2026-06-22, BE: 2026-06-18

Condition(s): Duchenne Muscular Dystrophy
Product: ENTR-601-45, ENTR-601-44

Primary endpoint: Incidence and severity of treatment emergent adverse events (TEAEs)., Changes in vital sign measurements., Changes in clinical laboratory results., Changes in electrocardiogram (ECG) parameters., Changes in physical examination findings.
Endpoint(s): Plasma concentration of study drug compounds and their final metabolite., Change from parent study Part A and OL Period baselines to LTE EOS in 10-Meter Walk/Run (10MWR)., Change from parent study Part A and OL Period baselines to LTE EOS in timed rise from floor (TRF)., Change from parent study Part A and OL Period baselines to LTE EOS in Timed 4-Stair Climb (4SC)., Change from parent study Part A and OL Period baselines to LTE EOS in stride velocity 95th centile (SV95C)., Change from parent study Part A and OL Period baselines to LTE EOS in North Star Ambulatory Assessment (NSAA)., Change from parent study Part A and OL Period baselines to LTE EOS in Performance of the Upper Limb v2.0 (PUL 2.0)., Anti-drug antibody (ADA) and anti-dystrophin antibody in serum.

Source: https://euclinicaltrials.eu/ctis-public/view/2025-525124-10-00